EU clinical trial 2023-504326-19-00: A single dose, randomized, double-blind, 2-way crossover clinical pharmacology study, to evaluate the lung availability and the systemic exposure of beclometasone dipropionate and beclometasone 17-monoproprionate (active metabolite of beclometasone dipropionate), after inhalation of CHF 718 pMDI HFA-152a 200 μg 4-inhalations in comparison with CHF 718 pMDI HFA-134a 200 μg 4-inhalations, using Volumatic® spacer in healthy volunteers.
Protocol code: CLI-00718AA2-02
Sponsor: Chiesi Farmaceutici S.p.A. (Pharmaceutical company). Phase: Human Pharmacology (Phase I)- Other. Countries: Belgium (ended).
Therapeutic area(s): Diseases [C] - Respiratory Tract Diseases [C08]
Gender: Female, Male. Age: 18-64 years. Enrolment: 71.
Status: Ended. Start date (EU): 2023-08-03. End date (EU): 2023-12-15. Decision date: 2023-07-19. Results received: Yes. Last updated: 2024-01-15.

Condition(s): Asthma
Product: Clenil Modulite 200 micrograms per metered dose Pressurised Inhalation Solution

Primary endpoint: BDP and B17MP: AUC0-t and Cmax will be log-transformed and analysed using a linear model including treatment, period, sequence and subject within sequence as fixed effects. The ratios of adjusted geometric means between T versus (vs.) R will be calculated with their 90% two-sided CIs. Bioequivalence between T vs. R will be demonstrated if the CI of the ratio is contained within the acceptance interval of 80%-125%;, BDP and B17MP: median tmax will be analysed with the Hodges Lehmann non-parametric estimate of location shift between treatments with its two-sided 90% CI will be provided.
Endpoint(s): The following variables will be log-transformed and analysed using the same model as for the primary PK variables: - BDP and B17MP: AUC0-∞ and t½; - BDP: AUC0-30min.

Source: https://euclinicaltrials.eu/ctis-public/view/2023-504326-19-00